EU clinical trial 2025-521315-39-00: EAST-1 (ERAP-inhibition in Axial Spondyloarthritis Trial-1)
Protocol code: GRWD0715-AS-01
Sponsor: Grey Wolf Therapeutics Limited (Pharmaceutical company). Phase: Human Pharmacology (Phase I)- First administration to humans. Countries: Belgium (authorised, recruiting), Germany (ongoing, recruiting), Netherlands (ongoing, recruiting), Spain (authorised, recruitment pending), Poland (ongoing, recruiting).
Therapeutic area(s): Diseases [C] - Hemic and Lymphatic Diseases [C15]
Gender: Female, Male. Age: 18-64 years, 65+ years. Enrolment: 36.
Start date (EU): 2025-11-05. Decision date: 2025-10-06. Results received: No. Last updated: 2026-06-03.
Decision dates by country: BE: 2025-10-06, DE: 2025-10-06, NL: 2025-10-07, ES: 2026-05-19, PL: 2026-06-03

Condition(s): Axial spondyloarthritis

Source: https://euclinicaltrials.eu/ctis-public/view/2025-521315-39-00